EU clinical trial 2022-502140-13-00: What is the optimal antithrombotic strategy in patients with atrial fibrillation having acute coronary syndrome or undergoing percutaneous coronary intervention?
Sponsor: St Antonius Hospital (Hospital/Clinic/Other health care facility). Phase: Therapeutic use (Phase IV). Countries: Netherlands (ongoing, recruiting), Belgium (ongoing, recruiting), Italy (ongoing, recruiting), Denmark (ongoing, recruiting).
Therapeutic area(s): Diseases [C] - Cardiovascular Diseases [C14]
Gender: Female, Male. Age: 18-64 years, 65+ years. Enrolment: 3000.
Status: Ongoing, recruiting. Start date (EU): 2023-01-11. Decision date: 2022-11-14. Results received: No. Last updated: 2026-02-23.
Decision dates by country: DK: 2025-01-22, IT: 2024-03-22, BE: 2023-07-18, NL: 2022-12-22

Condition(s): Atrial fibrillation; Acute coronary syndrome; Chronic coronary syndrome
Product: Lixiana 30 mg film-coated tablets, Clopidogrel Viatris 75 mg film-coated tablets, Prasugrel 5 mg film-coated tablets, TICAGRELOR MICRO LABS 90 mg, comprimé pelliculé, Lixiana 60 mg film-coated tablets, Aspirin 75mg Gastro-resistant Tablets

Primary endpoint: The safety endpoint is major or clinically relevant non-major bleeding as defined by the ISTH at 6 weeks after PCI., The co-primary efficacy endpoint is a composite of all-cause death, myocardial infarction, stroke, systemic embolism, or stent thrombosis at 6 weeks after PCI.
Endpoint(s): Key secondary endpoints include the primary safety and efficacy outcomes at 6 months after successful PCI., Exploratory analysis of the individual components of the main secondary endpoint, Net clinical benefit comprising of major bleeding, myocardial infarction, stroke, systemic embolism, all cause death, and stent thrombosis, Quality of life

Source: https://euclinicaltrials.eu/ctis-public/view/2022-502140-13-00